EU clinical trial 2024-513977-31-00: A phase II trial of radiotherapy-durvalumab without prophylactic neck irradiation in squamous cell carcinoma of the head and neck (REWRITe)
Protocol code: GORTEC 2018-02
Sponsor: Groupe Oncologie Radiotherapie Tete Cou (Patient organisation/association). Phase: Therapeutic exploratory (Phase II). Countries: France (ended).
Therapeutic area(s): Diseases [C] - Neoplasms [C04]
Gender: Female, Male. Age: 18-64 years, 65+ years. Enrolment: 61.
Status: Ended. Start date (EU): 2019-07-17. End date (EU): 2026-03-09. Decision date: 2024-07-24. Results received: No. Last updated: 2024-07-24.

Condition(s): Untreated squamous cell carcinoma of the head and neck
Product: IMFINZI 50 mg/mL concentrate for solution for infusion.

Primary endpoint: Regional (neck) nodal control rate at 1 year
Endpoint(s): Early and late adverse events of grade ≥ 2, according to the CTCAE V5.0, Local control at the primary site, Locoregional nodal + primary site control rate, Distant metastases control rate, Ultimate regional control including salvage surgery and/or salvage RT), Overall survival, Objective Response Rate, Progression-free survival, QLQ C30 and QLQ-H&N35 scores at baseline, 3, 12 and 24 months post RT

Source: https://euclinicaltrials.eu/ctis-public/view/2024-513977-31-00